EU clinical trial 2025-524330-25-00: Phase 1, Randomized, Open-label, Single center study to evaluate Pharmacokinetic and Bioequivalence of Levonorgestrel Vaginal Delivery System in Healthy Female Volunteers after different days of use
Protocol code: LR-105
Sponsor: Chemo Research S.L. (Pharmaceutical company). Phase: Human Pharmacology (Phase I)- Other. Countries: Spain (ongoing, recruiting).
Therapeutic area(s): Not possible to specify
Gender: Female. Age: 18-64 years. Enrolment: 60.
Status: Ongoing, recruiting. Start date (EU): 2026-04-21. Decision date: 2026-03-27. Results received: No. Last updated: 2026-03-27.

Condition(s): No medical condition

Source: https://euclinicaltrials.eu/ctis-public/view/2025-524330-25-00